EU clinical trial 2023-508945-41-00: An Open-Label, Prospective, Multi-Center Clinical Trial to Evaluate the Efficacy and Safety of TheraSphere™ Followed by Durvalumab (Imfinzi®) with Tremelimumab (Imjudo®) for Hepatocellular Carcinoma (HCC)
Protocol code: S2472
Sponsor: Biocompatibles UK Limited (Pharmaceutical company). Phase: Therapeutic exploratory (Phase II). Countries: Spain (ongoing, recruitment ended), France (ongoing, recruitment ended), Italy (ongoing, recruitment ended).
Therapeutic area(s): Diseases [C] - Digestive System Diseases [C06]
Gender: Female, Male. Age: 18-64 years, 65+ years. Enrolment: 81.
Status: Ongoing, recruitment ended. Start date (EU): 2023-10-11. Decision date: 2023-11-14. Results received: No. Last updated: 2026-06-04.
Decision dates by country: IT: 2024-09-04, ES: 2023-11-14, FR: 2023-12-05

Condition(s): Hepatocellular Carcinoma
Product: Remicade 100 mg powder for concentrate for solution for infusion., IMFINZI 50 mg/mL concentrate for solution for infusion., IMJUDO 20 mg/ml concentrate for solution for infusion., CellCept 500 mg powder for concentrate for solution for infusion

Primary endpoint: Primary Effectiveness Endpoint Objective response rate (ORR: complete response and partial response) evaluated by modified Response Evaluation Criteria in Solid Tumors (mRECIST) by investigator assessment Primary Safety Endpoint Number of adverse events (AEs) and serious adverse events (SAEs)
Endpoint(s): Number of immune mediated AEs and SAEs., Number of patients whose durvalumab and/or tremelimumab treatment was temporarily halted, postponed, or permanently discontinued due to an AE., Change from baseline in liver function tests (aspartate aminotransferase [AST], alanine aminotransferase [ALT], gamma-glutamyl transpeptidase [GGT], alkaline phosphatase [ALP], bilirubin, albumin)., Change from baseline in Child-Pugh score, Change from baseline in Albumin Bilirubin (ALBI) score., Change from baseline in Eastern Cooperative Oncology Group (ECOG) score, ORR according to localized mRECIST# and RECIST 1.1. #Localized mRECIST is defined as mRECIST assessment within the TheraSphere treatment area. The TheraSphere treatment area is the liver volume infused with TheraSphere., Disease Control Rate (DCR) according to mRECIST, localized mRECIST#, and RECIST 1.1, Duration of disease control (DoDC) according to mRECIST, localized mRECIST#, and RECIST 1.1, Time to best response (Complete Response [CR] or Partial Response [PR]) according to mRECIST, localized mRECIST#, and RECIST 1.1., Complete Response Rate (CRR) according to mRECIST, localized mRECIST#, and RECIST 1.1., Duration of Complete Response (DoCR) according to mRECIST, localized mRECIST#, and RECIST 1.1., Hepatic Time to Progression (hTTP) according to mRECIST, and RECIST 1.1, Time to Progression (TTP) according to mRECIST, localized mRECIST#, and RECIST 1.1., Progression Free Survival (PFS) according to mRECIST, localized mRECIST#, and RECIST 1.1; this will include an evaluation of the PFS rate at 6, 12, 18, and 24 months, Hepatic Progression Free Survival (hPFS) by mRECIST and RECIST 1.1., Overall survival (OS), Disease specific survival (DSS), Proportion of patients receiving subsequent treatment for HCC after study treatment, and type of HCC treatment received., Proportion of patients to undergo surgery (transplantation or resection)., Time to subsequent anti-cancer treatment for HCC (local or systemic therapy)., Reason for starting subsequent anti-cancer treatment for HCC, Alpha-fetoprotein (AFP) response., Change from baseline in Quality of Life (QoL) by Functional Assessment of Cancer Therapy – Hepatobiliary (FACT-Hep)., Change from baseline in QoL by EuroQol-5D (EQ-5D)., Pre- treatment volumes will be determined using baseline CT/MRI angiography or cone beam computed tomography (CBCT) or single photon emission computerized tomography/computed tomography (SPECT/CT) following Technetium-99m macroaggregated albumin (99mTc-MAA) and Symplicit90Y software, Association between tumoral absorbed doses, determined by 99mTc-MAA SPECT/CT, with efficacy endpoints, Association between perfused liver absorbed doses, determined by 99mTc-MAA SPECT/CT, with efficacy endpoints, Association between normal tissue absorbed doses, determined by 99mTc-MAA SPECT/CT, with safety endpoints., Association between tumoral absorbed doses, determined by Y-90 PET/CT or PET/MRI or Y-90 SPECT/CT, with efficacy endpoints, Association between perfused liver absorbed doses, determined by Y-90 PET/CT or PET/MRI or Y-90 SPECT/CT, with efficacy endpoints., Association between normal tissue absorbed doses, determined by 99mTc-MAA SPECT/CT and by Y-90 PET/CT or PET/MRI or Y-90 SPECT/CT, Determination of dose volume histogram (DVH) for tumoral VOIs and normal liver tissue VOIs, using 99mTc-MAA SPECT/CT and Y-90 PET or SPECT/CT., Whole liver and remnant liver volumes at baseline and follow-up volume imaging assessments measured using Simplicit90Y software, Association between normal tissue absorbed doses, determined by Y-90 PET/CT or PET/MRI or Y-90 SPECT/CT, with safety endpoints., Association between tumoral absorbed doses, determined by 99mTc-MAA SPECT/CT and Y-90 PET/CT or PET/MRI or Y-90 SPECT/CT., Association between perfused liver absorbed doses, determined by 99mTc-MAA SPECT/CT and Y-90 PET/CT or PET/MRI or Y-90 SPECT/CT.

Source: https://euclinicaltrials.eu/ctis-public/view/2023-508945-41-00